EU clinical trial 2025-522555-26-00: OCTAGON:A Phase 4, Single Arm Study to Investigate Oral Corticosteroid Tapering in Adult Patients with Generalized Myasthenia Gravis Treated with Ravulizumab
Protocol code: ALX-MG-502
Sponsor: Alexion Pharmaceuticals Inc. (Pharmaceutical company). Phase: Therapeutic use (Phase IV). Countries: Italy (authorised, recruitment pending), Germany (authorised, recruitment pending).
Therapeutic area(s): Diseases [C] - Nervous System Diseases [C10]
Gender: Female, Male. Age: 18-64 years, 65+ years. Enrolment: 15.
Status: Authorised, recruitment pending. Decision date: 2026-06-08. Results received: No. Last updated: 2026-06-09.
Decision dates by country: DE: 2026-06-08, IT: 2026-06-09

Condition(s): Generalized Myasthenia Gravis
Product: PREDNISONE, Ultomiris 1,100 mg/11 mL concentrate for solution for infusion, Ultomiris 300 mg/3 mL concentrate for solution for infusion, PREDNISONE, PREDNISONE, PREDNISONE, PREDNISOLONE

Primary endpoint: Proportion of adult participants with gMG who either: • Discontinue OCS (0 mg/day), or • Reduce their daily OCS dosage ≤ 5 mg/day, if the reason for no further OCS reduction is suspected adrenal insufficiency and maintain this status for ≥ 4 weeks without clinical deterioration of gMG
Endpoint(s): Proportion of adult participants with gMG who discontinue OCS (0 mg/day), sustained ≥ 4 weeks without clinical deterioration of gMG, Percentage change from daily OCS dose (mg/day) at baseline to the daily OCS dose (mg/day) at 4 weeks after OCS tapering is complete, Change from Baseline to 4 weeks after OCS tapering is complete in the MG-QoL-15r among adult participants with gMG • Change from Baseline to 4 weeks after OCS tapering is complete in MG-ADL total score among adult participants with gMG, Summary of GTI-MD including Cumulative Worsening Score and Aggregate Improvement Score at 4 weeks after OCS tapering is complete as assessed by BMI, glucose intolerance, blood pressure, and low-density lipoprotein collected at Baseline and at 4 weeks after OCS tapering is complete among adult participants with gMG, Proportion of adult participants with gMG with MG clinical deterioration events (including crises, exacerbations, MG-related hospitalization) at any time over the follow-up period • Proportion of adult participants with gMG with suspected adrenal insufficiency, based on symptoms as assessed at any time during the follow-up period, Proportion of adult participants with gMG with adrenal insufficiency confirmed by morning cortisol • Incidence of adverse events and serious adverse events among adult participants with gMG after initiation of reduction in OCS dose • Change from Baseline to 4 weeks after OCS tapering completion in laboratory parameters including HbA1c and LDL-C in adult participants with gMG, Summary of the Social Impact and Sleep questionnaire at 4 weeks after OCS tapering is complete among adult participants with gMG.

Source: https://euclinicaltrials.eu/ctis-public/view/2025-522555-26-00